EU clinical trial 2024-518528-54-00: A Phase 1 Study of the Safety and Preliminary Efficacy of CTX112 in Adult Subjects With Refractory Autoimmune Disease.
Protocol code: CRSP-AID-500
Sponsor: CRISPR Therapeutics AG (Pharmaceutical company). Phase: Human Pharmacology (Phase I)- First administration to humans. Countries: Germany (ongoing, recruiting), Spain (authorised, recruiting), France (authorised, recruitment pending).
Therapeutic area(s): Diseases [C] - Immune System Diseases [C20]
Gender: Female, Male. Age: 18-64 years, 65+ years. Enrolment: 51.
Start date (EU): 2025-12-02. Decision date: 2025-04-14. Results received: No. Last updated: 2026-08-03.
Decision dates by country: DE: 2025-04-14, FR: 2026-08-03, ES: 2025-12-18

Condition(s): Active systemic lupus erythematosus (SLE), systemic sclerosis (SSc), or idiopathic inflammatory myopathy (IIM).

Source: https://euclinicaltrials.eu/ctis-public/view/2024-518528-54-00